EU clinical trial 2023-506863-32-00: A Study to Investigate the Safety, Tolerability, Immunogenicity, Pharmacokinetics, and Pharmacodynamics of Ascending Intravenous Doses of Glofitamab, Administered after Ocrelizumab Pretreatment, in Patients with Multiple Sclerosis
Protocol code: BN44083
Sponsor: F. Hoffmann-La Roche AG (Pharmaceutical company). Phase: Human Pharmacology (Phase I)- Other. Countries: Croatia (ended), Czechia (ended).
Therapeutic area(s): Diseases [C] - Nervous System Diseases [C10]
Gender: Female, Male. Age: 18-64 years. Enrolment: 5.
Status: Ended. Start date (EU): 2023-07-25. End date (EU): 2026-01-19. End date: 2026-01-29. Decision date: 2024-07-11. Results received: No. Last updated: 2025-09-03.
Decision dates by country: CZ: 2024-07-12, HR: 2024-07-11

Condition(s): Multiple Sclerosis (MS)

Source: https://euclinicaltrials.eu/ctis-public/view/2023-506863-32-00